EU clinical trial 2024-513540-29-00: Randomized, Open Label, Phase III Trial to Evaluate the Efficacy and Safety of Palbociclib + Anti-HER2 Therapy + Endocrine Therapy vs. Anti-HER2 Therapy + Endocrine Therapy after Induction Treatment for Hormone Receptor Positive (HR+)/HER2-Positive Metastatic Breast Cancer
Protocol code: AFT-38
Sponsor: Alliance Foundation Trials LLC (Pharmaceutical company). Phase: Therapeutic confirmatory (Phase III). Countries: Italy (ongoing, recruitment ended), Portugal (ongoing, recruitment ended), Germany (ongoing, recruitment ended), France (ongoing, recruitment ended), Spain (ongoing, recruitment ended).
Therapeutic area(s): Diseases [C] - Neoplasms [C04]
Gender: Female, Male. Age: 18-64 years, 65+ years. Enrolment: 303.
Status: Ongoing, recruitment ended. Start date (EU): 2024-11-07. Decision date: 2024-11-07. Results received: No. Last updated: 2026-02-23.
Decision dates by country: ES: 2024-11-07, IT: 2024-11-18, PT: 2024-11-14, FR: 2024-11-18, DE: 2024-11-11

Condition(s): Breast Cancer
Product: IBRANCE 125 mg hard capsules, LETROZOLE, TRIPTORELIN, ANASTROZOLE, IBRANCE 75 mg hard capsules, TRASTUZUMAB, PERTUZUMAB, GOSERELIN, IBRANCE 100 mg hard capsules, LEUPRORELIN, FULVESTRANT, EXEMESTANE

Primary endpoint: Progression-free survival (PFS) as assessed by the Investigator
Endpoint(s): Overall Survival (OS), 3-year and 5-year survival probabilities, Objective response (OR: CR or PR), Duration of response (DOR), Clinical Benefit Rate (CBR: CR or PR or SD ≥ 24 weeks), Incidence of CNS metastasis, Safety: Type, incidence, severity (as graded by the NCI CTCAE v. 4.0), seriousness and attribution to the study medications of AEs and any laboratory abnormalities, Patient Reported Outcomes: Time to symptom progression (FACT-B PFB-TOI), breast cancer specific health treatment related quality of life and general health status

Source: https://euclinicaltrials.eu/ctis-public/view/2024-513540-29-00